EU clinical trial 2024-516783-29-00: Predictive factors and magnitude of response to omalizumab and mepolizumab in allergic and eosinophilic severe asthma: PREDICTUMAB, an open-label, controlled, randomized multinational pragmatic trial.
Protocol code: 2017/19JUI/325
Sponsor: Cliniques Universitaires Saint-Luc (Hospital/Clinic/Other health care facility). Phase: Therapeutic use (Phase IV). Countries: Belgium (ended), France (ended).
Therapeutic area(s): Diseases [C] - Respiratory Tract Diseases [C08]
Gender: Female, Male. Age: 18-64 years, 65+ years. Enrolment: 340.
Status: Ended. Start date (EU): 2018-04-16. End date (EU): 2025-06-12. Decision date: 2024-11-28. Results received: No. Last updated: 2025-04-15.
Decision dates by country: BE: 2024-11-28, FR: 2024-12-06

Condition(s): Severe allergic and eosinophilic asthma
Product: MEPOLIZUMAB, OMALIZUMAB

Primary endpoint: The primary criterion for judgment will be the rate of severe exacerbation during one year in patients on omalizumab vs mepolizumab, in the overall population. An additional primary criterion will be the rate of response to omalizumab vs that for mepolizumab, in the overall and stratified population(s).
Endpoint(s): Clinical features and biomarkers (or array signatures) analyzed in blood, mucosal and urine samples will be tested for their putative ability to predict a better response to oma- or mepolizumab (theranostic value). The candidate features are age at (severe) disease onset and presence of nasal polyps or aspirin hypersensitivity as well as serum specific/total IgE ratio and blood eosinophil levels., Asthma-related outcomes other than exacerbations – i.e. disease control reflected by ACT and ACQ6, asthma-related quality of life questionnaire reflected by AQLQ, lung function reflected by FEV1 % predicted and absolute change - as well as nasal symptoms (VAS and, for nasal polyps, endoscopic scoring) will be assessed in the oma- and mepolizumab groups, in the overall and stratified populations.

Source: https://euclinicaltrials.eu/ctis-public/view/2024-516783-29-00